EU clinical trial 2024-518362-27-00: CLEVER PEPTIDE : Open-label, non-controlled, multicenter, dose escalation, first-in-human clinical trial to evaluate the safety, pharmacokinetics and preliminary antitumor activity of intravenous PEP-010, administered as single agent and in combination with paclitaxel or with gemcitabine in patients with recurrent and/or metastatic solid cancer
Protocol code: IC 2018-06
Sponsor: Institut Curie (Hospital/Clinic/Other health care facility). Phase: Human Pharmacology (Phase I)- First administration to humans. Countries: France (ended).
Therapeutic area(s): Not possible to specify
Gender: Female, Male. Age: 18-64 years, 65+ years. Enrolment: 101.
Status: Ended. Start date (EU): 2021-05-18. End date (EU): 2026-06-11. Decision date: 2024-11-08. Results received: No. Last updated: 2025-11-28.
Decision dates by country: FR: 2025-01-14

Condition(s): Patients with recurrent and/or metastatic solid cancer.

Source: https://euclinicaltrials.eu/ctis-public/view/2024-518362-27-00